EU clinical trial 2024-515704-39-00: ISA-PET
Sponsor: Medical University Of Vienna (Educational Institution). Phase: Human Pharmacology (Phase I)- Other. Countries: Austria (authorised, recruiting).
Therapeutic area(s): Diseases [C] - Bacterial Infections and Mycoses [C01]
Gender: Female, Male. Age: 18-64 years, 65+ years. Enrolment: 20.
Status: Authorised, recruiting. Start date (EU): 2025-01-15. Decision date: 2024-12-20. Results received: No. Last updated: 2025-11-21.

Condition(s): Invasive Aspergillosis

Source: https://euclinicaltrials.eu/ctis-public/view/2024-515704-39-00